EU clinical trial 2023-510340-20-00: A study to investigate the safety and pharmacological effect of a single intravenous infusion of GSK2857914 in male and female participants aged 18 to 75 with moderate to severe systemic lupus erythematosus
Protocol code: 221615
Sponsor: Glaxosmithkline Research & Development Limited (Pharmaceutical company). Phase: Human Pharmacology (Phase I)- Other. Countries: Spain (ended), France (ended).
Therapeutic area(s): Diseases [C] - Immune System Diseases [C20]
Gender: Female, Male. Age: 18-64 years, 65+ years. Enrolment: 6.
Status: Ended. End date (EU): 2025-05-05. End date: 2025-05-06. Decision date: 2024-10-28. Results received: No. Last updated: 2025-02-26.
Decision dates by country: ES: 2024-10-28, FR: 2025-02-26

Condition(s): Systemic Lupus Erythematosus

Source: https://euclinicaltrials.eu/ctis-public/view/2023-510340-20-00